EU clinical trial 2025-521217-46-00: Impact of influenza vaccination on nasal resident memory immune responses and respiratory peripheral memory immune responses - MUCOVAC 2
Protocol code: 24CH249
Sponsor: Centre Hospitalier Universitaire De Saint Etienne (Hospital/Clinic/Other health care facility). Phase: Therapeutic use (Phase IV). Countries: France (ended).
Therapeutic area(s): Diseases [C] - Virus Diseases [C02]
Gender: Female, Male. Age: 18-64 years, 65+ years. Enrolment: 30.
Status: Ended. Start date (EU): 2025-12-02. End date (EU): 2026-01-22. Decision date: 2025-12-02. Results received: No. Last updated: 2025-12-02.

Condition(s): Adults seeking active immunisation against the seasonal influenza virus
Product: Flucelvax suspension for injection in pre-filled syringe Influenza vaccine (surface antigen, inactivated, prepared in cell cultures), VAXIGRIPTETRA, suspension injectable en seringue préremplie Vaccin grippal quadrivalent (inactivé, à virion fragmenté), INFLUVAC TETRA, suspension injectable en seringue préremplie Vaccin grippal inactivé à antigènes de surface

Primary endpoint: Frequency of resident memory lymphocytes in the nasal mucosa and expression rate of migration markers towards the respiratory mucosa on peripheral memory lymphocytes before and after intramuscular influenza vaccination: variation in frequency between before and after vaccination
Endpoint(s): The frequencies of resident memory T and B lymphocytes in the nasal cavity and the percentage of migration markers specific to the respiratory mucosa expressed on peripheral memory T and B lymphocytes., Correlation coefficients between the frequency of nasal resident memory lymphocytes, the percentage of migration markers expressed on peripheral memory lymphocytes, as well as anti-Influenza titers and Influenza neutralising antibody titers in mucosa and serum, the systemic cellular response specific to Influenza and the percentage of expression of genes involved in the systemic immune response.

Source: https://euclinicaltrials.eu/ctis-public/view/2025-521217-46-00